EU clinical trial 2022-502777-42-01: A Phase 3, Randomized, Double-Blind, Placebo-Controlled Study to Evaluate the Efficacy and Safety of MK-0616 in Adults With Hypercholesterolemia
Protocol code: MK-0616-013
Sponsor: Merck Sharp & Dohme LLC (Pharmaceutical company). Phase: Therapeutic confirmatory (Phase III). Countries: Italy (ended), Spain (ended), Germany (ended).
Therapeutic area(s): Diseases [C] - Cardiovascular Diseases [C14]
Gender: Female, Male. Age: 18-64 years, 65+ years. Enrolment: 299.
Status: Ended. Start date (EU): 2024-01-16. End date (EU): 2025-07-14. End date: 2025-07-28. Decision date: 2023-12-20. Results received: Yes. Last updated: 2025-08-15.
Decision dates by country: ES: 2023-12-22, IT: 2023-12-22, DE: 2023-12-20

Condition(s): Hypercholesterolemia
Product: Microcrystalline cellulose, Sodium Chloride, Magnesium Stearate, MK-0616

Primary endpoint: Percent Change from Baseline in Low-density Lipoprotein Cholesterol (LDL-C) at Week 24, Number of Participants Who Experience One or More Adverse Events (AEs), Number of Participants Who Discontinue Study Intervention Due to an AE
Endpoint(s): Percent Change from Baseline in Low-density Lipoprotein Cholesterol (LDL-C) at Week 52, Percent Change from Baseline in Non-High-density Lipoprotein Cholesterol (non-HDL-C), Percent Change from Baseline in Apolipoprotein B (ApoB), Percent Change from Baseline in Lipoprotein A [Lp(A)], Percentage of Participants with LDL-C <70 mg/dL and a ≥50% Reduction From Baseline in LDL-C, Percentage of Participants with LDL-C <55 mg/dL and a ≥50% Reduction From Baseline in LDL-C

Source: https://euclinicaltrials.eu/ctis-public/view/2022-502777-42-01